EU clinical trial 2025-524454-34-00: Randomized, double-blind, parallel-group clinical trial, compared with placebo to evaluate the efficacy and safety of three antibiotic treatment regimens for the eradication of primary P. aeruginosa infection in patients with bronchiectasis
Protocol code: IIBSP-PAB-2025-212
Sponsor: Fundacio Institut De Recerca De L'Hospital De La Santa Creu I Sant Pau (Hospital/Clinic/Other health care facility). Phase: Phase III and phase IV (Integrated). Countries: Spain (authorised, recruitment pending).
Therapeutic area(s): Diseases [C] - Respiratory Tract Diseases [C08]
Gender: Female, Male. Age: 18-64 years, 65+ years. Enrolment: 160.
Status: Authorised, recruitment pending. Decision date: 2026-06-09. Results received: No. Last updated: 2026-06-09.

Condition(s): Bronchiectasis
Product: 0.9% Sodium Chloride Intravenous Infusion Solution, Colfinair 2 millones de UI polvo para solución para inhalación por nebulizador, Ciprofloxacino Normon 250 mg comprimidos recubiertos con película EFG, Ciprofloxacino Normon 500 mg comprimidos recubiertos con película EFG, Celulosa Microcristalina: 98,05 g+ Sílice Coloidal: 1,95 g

Primary endpoint: Microbiological eradication of PA, measured by negative cultures from sputum or bronchoscopic sample (only if clinically performed as part of usual care) at 3 months after treatment initiation.
Endpoint(s): Early microbiological eradication at 1 and 2 months, Sustained eradication at 6 and 12 months., Exacerbation frequency, Safety, Quality of life, Serum biomarkers levels, Costs

Source: https://euclinicaltrials.eu/ctis-public/view/2025-524454-34-00